EU clinical trial 2025-524488-18-00: An Open-label, Single-Arm, Phase 2 Study to Evaluate Enfortumab Vedotin plus Pembrolizumab for Bladder Preservation in Participants with Muscle-invasive Bladder Cancer (EV-209).
Protocol code: 7465-CL-0209
Sponsor: Astellas Pharma Global Development Inc. (Pharmaceutical company). Phase: Therapeutic exploratory (Phase II). Countries: Germany (authorised, recruitment pending), France (authorised, recruitment pending), Poland (authorised, recruitment pending), Italy (authorised, recruitment pending), Spain (authorised, recruitment pending).
Therapeutic area(s): Diseases [C] - Neoplasms [C04]
Gender: Female, Male. Age: 18-64 years, 65+ years. Enrolment: 88.
Status: Authorised, recruitment pending. Decision date: 2026-06-22. Results received: No. Last updated: 2026-08-07.
Decision dates by country: FR: 2026-06-22, DE: 2026-06-23, IT: 2026-06-23, PL: 2026-06-29, ES: 2026-08-07

Condition(s): Muscle-invasive Bladder Cancer
Product: Padcev 30 mg powder for concentrate for solution for infusion, KEYTRUDA 395 mg solution for injection

Primary endpoint: Overall cCR rate after treatment with enfortumab vedotin in combination with pembrolizumab as assessed by investigator (FAS) - 2-year BI-EFS rate after treatment with enfortumab vedotin in combination with pembrolizumab as assessed by investigator (FAS1 analysis set)
Endpoint(s): Overall cCR rate after 4 cycles of treatment with enfortumab vedotin in combination with pembrolizumab as assessed by investigator (FAS) - 2-year BI-EFS rate after treatment with enfortumab vedotin in combination with pembrolizumab as assessed by investigator (FAS2 analysis set), OS (FAS1 analysis set), DFS as assessed by investigator (FAS1 analysis set), MFS as assessed by investigator (FAS1 analysis set), Type, incidence, relatedness, severity and seriousness of safety variables (AEs and laboratory tests), Treatment discontinuation rate due to AEs

Source: https://euclinicaltrials.eu/ctis-public/view/2025-524488-18-00